EU clinical trial 2024-512646-42-00: A Phase 2b, Multi-center, Randomized, Quadruple-blind, Placebo-controlled Study of Batoclimab Treatment in Adult Participants with Active Chronic Inflammatory Demyelinating Polyneuropathy (CIDP)
Protocol code: IMVT-1401-2401
Sponsor: Immunovant Sciences GmbH (Pharmaceutical company). Phase: Therapeutic exploratory (Phase II). Countries: Sweden (ended), Spain (ended), Norway (ended), Germany (ended), Denmark (ended), Poland (ended), Bulgaria (ended), Slovakia (ended), Finland (ended), Portugal (ended), Belgium (ended), Romania (ended), Greece (ended), Italy (ended).
Therapeutic area(s): Diseases [C] - Nervous System Diseases [C10]
Gender: Female, Male. Age: 18-64 years, 65+ years. Enrolment: 178.
Status: Ended. Start date (EU): 2023-06-27. End date (EU): 2026-04-17. End date: 2026-04-18. Decision date: 2024-08-27. Results received: No. Last updated: 2025-10-08.
Decision dates by country: SK: 2024-08-28, PL: 2024-09-22, SE: 2024-08-28, IT: 2024-09-24, DK: 2024-08-30, BG: 2024-09-16, GR: 2024-09-20, FI: 2024-08-27, NO: 2024-08-30, RO: 2024-09-04, PT: 2024-08-28, ES: 2024-08-29, DE: 2024-08-29, BE: 2024-08-28

Condition(s): Chronic Inflammatory Demyelinating Polyneuropathy (CIDP)
Product: Batoclimab, Placebo is identical to IMP but with no active substance.

Primary endpoint: Period 2 / Cohort A: Proportion of participants who remain relapse-free at Week 36 where relapse is defined as a worsening (increase) of ≥ 1 point on the Adj INCAT score at any time point during Period 2 relative to Period 2 baseline which is sustained at a Follow-Up visit 1 week later.
Endpoint(s): Period 2 / Cohort A: -Time to first relapse relative to Period 2 baseline - Change from Period 2 baseline to Week 36 in: Adj INCAT score, Inflammatory Rasch-built Overall Disability Scale (I-RODS), Mean Grip Strength, Medical Research Council (MRC) Sum Score, Overall Neuropathy Limitations Scale (ONLS), Period 2 / Cohort A and B combined: Change from Period 2 baseline to Week 36 in: Adj INCAT score, I-RODS, Mean Grip Strength, MRC Sum Score, ONLS, Period 2 / Cohorts A, B and C combined: Proportion of participants who remain relapse-free at Week 36.

Source: https://euclinicaltrials.eu/ctis-public/view/2024-512646-42-00